EU clinical trial 2023-509786-21-00: Interpectoral-pectoserratus plane block for minimally invasive aortic valve replacement via right anterior minithoracotomy: A single centre, prospective, double-blind, randomized controlled superiority trial
Sponsor: Az Maria Middelares Gent (Hospital/Clinic/Other health care facility). Phase: Therapeutic use (Phase IV). Countries: Belgium (ongoing, recruiting).
Therapeutic area(s): Analytical, Diagnostic and Therapeutic Techniques and Equipment [E] - Anesthesia and Analgesia [E03]
Gender: Female, Male. Age: 18-64 years, 65+ years. Enrolment: 144.
Status: Ongoing, recruiting. Start date (EU): 2024-09-01. Decision date: 2024-06-26. Results received: No. Last updated: 2026-04-27.

Condition(s): Aortic Valve disease
Product: Natriumchloride 0,9 % w/v, Viaflo, oplossing voor infusie, Levobupivacaïne Fresenius Kabi 2,5 mg/ml, oplossing voor injectie/infusie, Dipidolor 10 mg/ml oplossing voor injectie

Primary endpoint: The cumulative opioid consumption in the first 48 postoperative hours after the completion of the surgical procedure in patients undergoing AVR-RAT procedures which is expressed in OMEs
Endpoint(s): Number of episodes of postoperative pain (NRS score ≥ 4) at rest and at deep inspiration in the first 48 postoperative hours after the completion of the surgical procedure, Time to need for rescue medication for breakthrough pain (e.g. tramadol, oxycodone) in the first 48 postoperative hours after the completion of the surgical procedure, Number of patients with respiratory complications, leading to non-invasive ventilation (NIV) or high-flow nasal cannula (HFNC) oxygen therapy, orotracheal intubation for more than 24 hours or orotracheal re-intubation, Levels of PaCO2 measured every 4 hours during the 48 postoperative hours after the completion of the surgical procedure or until ICU discharge, whichever occurs first, Postsurgical recovery by QoR-15NL questionnaire on day before, first, second and seventh day after surgery, Number of episodes of PONV in the first 48 postoperative hours, Time to extubation of the patient in the ICU, Number of hours spent in the ICU (until ready for discharge), Number of days in the hospital between surgery and first hospital discharge, The quality of life (QoL) by the EQ-5D questionnaire on the day before surgery and 30 days after surgery, Number of days alive and at home after surgery (DAH30), Vital status at 30 days after surgery

Source: https://euclinicaltrials.eu/ctis-public/view/2023-509786-21-00